EU clinical trial 2024-511608-18-00: A Phase 2b, Open-label, Multi-arm Clinical Trial of Selinexor Plus Low-dose Dexamethasone (Sd) in Patients with Penta-refractory Multiple Myeloma or Selinexor and Bortezomib Plus Low-dose Dexamethasone (SVd) in Patients with Triple-class Refractory Multiple Myeloma
Protocol code: XPORT-MM-028
Sponsor: Karyopharm Therapeutics Inc. (Pharmaceutical company). Phase: Therapeutic exploratory (Phase II). Countries: Greece (ongoing, recruiting).
Therapeutic area(s): Diseases [C] - Neoplasms [C04]; Diseases [C] - Hemic and Lymphatic Diseases [C15]
Gender: Female, Male. Age: 18-64 years, 65+ years. Enrolment: 55.
Status: Ongoing, recruiting. Start date (EU): 2020-06-25. Decision date: 2024-09-23. Results received: No. Last updated: 2026-06-17.

Condition(s): Penta-refractory multiple myeloma and triple-class refractory multiple myeloma
Product: SELINEXOR, Ondansetron Aurobindo 8 mg Filmtabletten, ZYPREXA 2.5 mg coated tablets, Bortezomib Accord 3.5 mg powder for solution for injection, Dexamethasone 4 mg tablets

Primary endpoint: ORR defined as the proportion of patients who achieve stringent complete response (sCR), complete response (CR), very good partial response (VGPR), or partial response (PR) as assessed by the Investigator based on International Myeloma Working Group (IMWG) response criteria will be analyzed separately for each arm
Endpoint(s): The following endpoints will be analyzed separately for each arm: • Duration of response (DOR) • Clinical benefit rate (CBR) • Disease control rate (DCR) • Progression-free survival (PFS) • Overall survival (OS) • Time to next treatment (TTNT), The safety and tolerability of study drug will be evaluated based on AE reports, vital signs, and clinical laboratory results by means of the occurrence, nature, and severity of AEs as categorized by the Common Terminology Criteria for Adverse Events (CTCAE) v5.0

Source: https://euclinicaltrials.eu/ctis-public/view/2024-511608-18-00